EU clinical trial 2024-511028-15-00: A phase 2, randomized, patient and assessor blind, multicentre study comparing foetal neural stem cells transplantation to sham procedure in progressive multiple sclerosis (STEMS2)
Protocol code: STEMS2
Sponsor: Ospedale San Raffaele S.r.l. (Hospital/Clinic/Other health care facility). Phase: Therapeutic exploratory (Phase II). Countries: Italy (ongoing, recruiting).
Therapeutic area(s): Diseases [C] - Nervous System Diseases [C10]
Gender: Female, Male. Age: 18-64 years, 65+ years. Enrolment: 86.
Status: Ongoing, recruiting. Start date (EU): 2025-11-20. Decision date: 2024-08-12. Results received: No. Last updated: 2026-04-02.

Condition(s): Progressive Multiple Sclerosis
Product: human fetal neural precursor cells, TACROLIMUS

Primary endpoint: Change in whole brain volume evaluated through magnetic resonance imaging (MRI) in 96 weeks (W) of follow-up
Endpoint(s): Rate and nature of the adverse events, classified according to the Common Terminology Criteria for Adverse Events (CTCAE) version 5.0 and attributed to the investigational medicinal product accordingly to national cancer institute (NCI) guidelines of adverse event (AE) reporting requirements., Percentage change in brain grey matter volume evaluated through MRI in 96 weeks of follow-up., Percentage change in brain white matter volume evaluated through MRI in 96 weeks of follow-up., Proportion of patients with no evidence of 24-weeks confirmed disability progression (defined as progression by 1 step on the Expanded Disability Status Scale (EDSS) in patients with EDSS ≤ 5.5 or of 0.5 EDSS steps in patients with EDSS ≥ 6, confirmed after 24 weeks interval) in 96 weeks of follow-up, Proportion of patients with no evidence of progression (defined as no progression sustained for at least 24 weeks on all of the following three components: confirmed disability progression; ≥20% increase in timed 25-foot walk test [T25FWT]; ≥20% increase in nine-hole peg test [9HPT]. The T25FWT will not be considered for patients who are unable to complete the test at baseline [EDSS score ≥ 7.0] in 96 weeks of follow-up., Proportion of patients with no active disease, defined as no clinical relapses, no enlarging or new T2 hyperintense lesions, and no gadolinium (Gd+)-enhancing lesions in 96 weeks of follow-up., Change in cognitive function as measured by the symbol digit modalities test (SDMT) in 96 weeks of follow-up.

Source: https://euclinicaltrials.eu/ctis-public/view/2024-511028-15-00